EU clinical trial 2024-517429-24-00: An open-label, dose-escalation, phase I/II study to assess the safety, the tolerability, the immunogenicity and the preliminary clinical activity of the therapeutic cancer vaccine, PDC*lung01, associated or not with anti-PD-1 treatment in patients with non-small-cell lung cancer (NSCLC)
Protocol code: PDC-LUNG-101
Sponsor: PDC line pharma (Pharmaceutical company). Phase: Phase I and Phase II (Integrated)- First administration to humans. Countries: France (ended), Germany (ended), Netherlands (ended), Poland (ended), Belgium (ended).
Therapeutic area(s): Diseases [C] - Neoplasms [C04]
Gender: Female, Male. Age: 18-64 years, 65+ years. Enrolment: 64.
Status: Ended. Start date (EU): 2020-01-09. End date (EU): 2025-09-30. Decision date: 2024-10-29. Results received: Yes. Last updated: 2025-06-17.
Decision dates by country: BE: 2024-10-29, FR: 2024-10-30, DE: 2024-11-13, PL: 2024-11-08, NL: 2024-11-05

Condition(s): Non-small-cell lung cancer
Product: ALIMTA 500 mg powder for concentrate for solution for infusion, ALIMTA 100 mg powder for concentrate for solution for infusion, KEYTRUDA 25 mg/mL concentrate for solution for infusion, PDC*lung01, PDC*lung01

Primary endpoint: Occurrence of dose-limiting toxicities (DLT) related to the administration of PDC*lung01
Endpoint(s): Occurrence of serious adverse events (SAEs) and adverse events (AEs), deemed as related to the association of PDC*lung01 and the anti-PD-1 therapy, monitored during study treatment until 28 days after the last dose of PDC*lung01, Occurrence of serious adverse events (SAEs) and adverse events (AEs), monitored during study treatment until 28 days after the last dose of PDC*lung01, Measurement of anti-HLA class I and II antibodies in the serum. In case of positive detection, the allelic specificity of the antibodies will be determined, Ex vivo detection and characterization of CD8+ T cells against tumor antigens borne by PDC*lung01, using flow cytometry, Objective Response Rate (according to RECIST version 1.1) for cohort B2, Objective Response Rate (according to iRECIST) for cohort B2, Progression-Free Survival at 9 months according to RECIST 1.1 and according to iRECIST from the first day of anti-PD-1 antibody administration for cohort B2

Source: https://euclinicaltrials.eu/ctis-public/view/2024-517429-24-00